EU clinical trial 2024-513534-38-00: The PHENOSAR trial: Antibiotic treatment of biopsy confirmed phenotypes in sarcoidosis: a proof of concept clinical trial.
Protocol code: NL73729.100.21
Sponsor: Sint Antonius Ziekenhuis Stichting (Hospital/Clinic/Other health care facility). Phase: Therapeutic use (Phase IV). Countries: Netherlands (ended).
Therapeutic area(s): Diseases [C] - Respiratory Tract Diseases [C08]
Gender: Female, Male. Age: 18-64 years, 65+ years. Enrolment: 40.
Status: Ended. Start date (EU): 2021-08-11. End date (EU): 2026-05-18. Decision date: 2024-05-13. Results received: No. Last updated: 2026-07-13.

Condition(s): sarcoidosis
Product: DOXICLAT 100 mg comprimidos recubiertos con película, Azithran 500 mg επικαλυμμένα με λεπτό υμένιο δισκία

Primary endpoint: Reduction of sarcoidosis related inflammation.

Source: https://euclinicaltrials.eu/ctis-public/view/2024-513534-38-00